EU clinical trial 2023-506871-88-00: A Study to Assess Adverse Events and Change in Disease Activity of Intravenously (IV) Infused Etentamig (ABBV-383) in Combination With Anti-Cancer Regimens for the Treatment of Adult Participants With Relapsed/Refractory Multiple Myeloma
Protocol code: M22-947
Sponsor: AbbVie Deutschland GmbH & Co. KG (Pharmaceutical company). Phase: Human Pharmacology (Phase I)- Other. Countries: Germany (ongoing, recruitment ended), Italy (ongoing, recruitment ended), Spain (ongoing, recruitment ended), Poland (ongoing, recruitment ended).
Therapeutic area(s): Diseases [C] - Neoplasms [C04]
Gender: Female, Male. Age: 18-64 years, 65+ years. Enrolment: 196.
Status: Ongoing, recruitment ended. Start date (EU): 2022-10-07. Decision date: 2024-01-10. Results received: No. Last updated: 2026-02-26.
Decision dates by country: DE: 2024-01-10, ES: 2024-01-15, IT: 2024-01-12, PL: 2024-03-15

Condition(s): Relapsed/Refractory Multiple Myeloma

Source: https://euclinicaltrials.eu/ctis-public/view/2023-506871-88-00